EU clinical trial 2023-504040-34-01: A Phase 3b, Open-label, Multicenter Study to Evaluate Transmural Healing and Disease Modifying Effect of Guselkumab in Crohn’s Disease Patients
Protocol code: CNTO1959CRD3008
Sponsor: Janssen - Cilag International (Pharmaceutical company). Phase: Therapeutic confirmatory (Phase III). Countries: Germany (ongoing, recruitment ended), Poland (ongoing, recruitment ended), Czechia (ongoing, recruitment ended), Slovakia (ongoing, recruitment ended), Spain (ongoing, recruitment ended), France (ongoing, recruitment ended), Italy (ongoing, recruitment ended), Belgium (ongoing, recruitment ended).
Therapeutic area(s): Diseases [C] - Digestive System Diseases [C06]
Gender: Female, Male. Age: 18-64 years, 65+ years. Enrolment: 151.
Status: Ongoing, recruitment ended. Start date (EU): 2024-11-12. Decision date: 2024-10-29. Results received: No. Last updated: 2026-03-31.
Decision dates by country: CZ: 2024-11-01, ES: 2024-10-29, DE: 2024-10-31, PL: 2024-10-31, FR: 2025-07-03, SK: 2024-10-30, IT: 2024-10-30, BE: 2025-07-31

Condition(s): Crohn’s Disease
Product: Guselkumab - solution for injection in pre-filled syringe - 100 mg/mL, Guselkumab, Guselkumab- Solution for infusion- 10 mg/ml

Primary endpoint: Proportion of participants achieving a Magnetic Resonance Index of Activity (MaRIA) <11 in all intestinal segments, at Week 48.

Source: https://euclinicaltrials.eu/ctis-public/view/2023-504040-34-01